EU clinical trial 2024-517923-38-00: A Study of an IDH1m Inhibitor in Participants with IDH1-Mutated Malignancies and Hepatic or Renal Impairment
Protocol code: S095031-218
Sponsor: Institut De Recherches Internationales Servier IRIS (Pharmaceutical company). Phase: Human Pharmacology (Phase I)- Other. Countries: Czechia (authorised, recruiting), Spain (ongoing, recruiting).
Therapeutic area(s): Diseases [C] - Neoplasms [C04]
Gender: Female, Male. Age: 18-64 years, 65+ years. Enrolment: 25.
Start date (EU): 2025-12-10. Decision date: 2025-11-24. Results received: No. Last updated: 2026-03-16.
Decision dates by country: CZ: 2025-11-24, ES: 2025-11-25

Condition(s): Newly diagnosed and/or previously treated IDH1-mutated malignancies

Source: https://euclinicaltrials.eu/ctis-public/view/2024-517923-38-00